EU clinical trial 2025-522097-36-00: A DOUBLE-BLIND, PLACEBO-CONTROLLED, RANDOMIZED, MULTIPLE RISING DOSE STUDY TO EVALUATE THE SAFETY, TOLERABILITY, PHARMACOKINETICS AND PHARMACODYNAMICS OF DEURUXOLITINIB IN HEALTHY ADULTS
Protocol code: CP543.1017
Sponsor: Sun Pharmaceutical Industries Inc. (Pharmaceutical company). Phase: Human Pharmacology (Phase I)- Other. Countries: Romania (ongoing, recruiting).
Therapeutic area(s): Diseases [C] - Immune System Diseases [C20]
Gender: Female, Male. Age: 18-64 years. Enrolment: 30.
Status: Ongoing, recruiting. Start date (EU): 2025-11-19. Decision date: 2025-10-27. Results received: No. Last updated: 2025-10-27.

Condition(s): alopecia areata

Source: https://euclinicaltrials.eu/ctis-public/view/2025-522097-36-00